EU clinical trial 2024-516068-27-01: Treatment of ELectroencephalographic STatus epilepticus After cardiopulmonary Resuscitation-2 (TELSTAR-2): a multicenter randomised clinical trial and health economic evaluation of anti-seizure treatment in comatose cardiac arrest patients with status epilepticus on continuous EEG.
Sponsor: Universiteit Twente (Educational Institution). Phase: Therapeutic confirmatory (Phase III). Countries: Belgium (ongoing, recruiting), Netherlands (ongoing, recruiting).
Therapeutic area(s): Diseases [C] - Cardiovascular Diseases [C14]
Gender: Female, Male. Age: 18-64 years, 65+ years. Enrolment: 150.
Status: Ongoing, recruiting. Start date (EU): 2025-04-10. Decision date: 2025-03-25. Results received: No. Last updated: 2026-07-01.
Decision dates by country: BE: 2025-03-25, NL: 2025-03-27

Condition(s): status epilepticus, cardiac arrest, comatose, cardiopulmonary resuscitation
Product: Midazolam Eugia 1 mg/ml, oplossing voor injectie/infusie of rectale toediening, Keppra 100 mg/ml concentrate for solution for infusion, Esketiv 25 mg/ml, oplossing voor injectie, Propofol 10 mg/ml MCT/LCT Fresenius emulsie voor injectie of infusie, Diazepam CF 5 mg/ml, oplossing voor injectie, Lorazepam Macure 4 mg/ml oplossing voor injectie, Depakine i.v. 400, poeder voor injectievloeistof 400 mg, Vimpat 10 mg/ml solution for infusion

Primary endpoint: The primary outcome measure will be functional recovery expressed as the score on the extended Glasgow Outcome Scale (eGOS) at six months after cardiac arrest. eGOS scores at six months are obtained by a standardized telephone interview conducted by an independent investigator, who is masked to treatment allocation and EEG pattern.
Endpoint(s): Cost-effectiveness analysis outcomes are Quality Adjusted Life Years (QALYs), costs, Incremental Cost Effectiveness Ratio (ICER), incremental cost-effectiveness plane, and incremental cost-effectiveness acceptability curve.

Source: https://euclinicaltrials.eu/ctis-public/view/2024-516068-27-01